EU clinical trial 2024-516621-31-00: Intranasal nafarelin compared to subcutaneous triptorelin for triggering final oocyte maturation in ovarian stimulation: a non-inferiority randomised controlled clinical trial
Protocol code: FSD-NAF-2024-11
Sponsor: Santiago Dexeus Font Fundacio Privada (Laboratory/Research/Testing facility). Phase: Therapeutic use (Phase IV). Countries: Spain (authorised, recruitment pending).
Therapeutic area(s): Diseases [C] - Female Urogenital Diseases and Pregnancy Complications [C13]
Gender: Female. Age: 18-64 years. Enrolment: 154.
Status: Authorised, recruitment pending. Decision date: 2024-12-09. Results received: No. Last updated: 2026-06-01.

Condition(s): Infertility
Product: Synarel 200 microgramos solución para pulverización nasal, Decapeptyl diario 0,1 mg polvo y disolvente para solución inyectable

Primary endpoint: The number of MII oocytes retrieved.
Endpoint(s): Total number of oocytes collected, Ovarian Hyperstimulation Syndrome, Other side effects/adverse effects, Cost, Serum LH and FSH levels 12 hours after trigger, Serum LH, FSH and progesterone levels at the time of oocyte collection, Participant reported pain, ease of use and medication preference

Source: https://euclinicaltrials.eu/ctis-public/view/2024-516621-31-00